EU clinical trial 2025-521520-29-00: The headache-inducing effects of cilostazol in men and women with migraine without aura
Sponsor: Syddansk Universitet (University of Southern Denmark) (Educational Institution). Phase: Phase I and Phase II (Integrated)- Other. Countries: Denmark (ongoing, recruiting).
Therapeutic area(s): Diseases [C] - Cardiovascular Diseases [C14]
Gender: Female, Male. Age: 18-64 years. Enrolment: 29.
Status: Ongoing, recruiting. Start date (EU): 2025-11-21. Decision date: 2025-06-20. Results received: No. Last updated: 2025-06-20.

Condition(s): Migraine
Product: Cilostazol AL 100 mg Tabletten, White, round, convex tablets with a diameter of 8 mm containing no active pharmaceutical ingredient. The composition (per 1000 tablets) includes lactose monohydrate (85 g), potato starch (86 g), gelatin A (3 g), purified water (72 g) and magnesium stearate (0.9 g), talc (8.1 g)., Ibuprofen Teva 400 mg, omhulde tabletten, Sumatriptan Accord 100 mg, filmomhulde tabletten

Primary endpoint: The difference in the incidence of migraine-like attacks during the entire observational period (until 12 hours post-administration) between cilostazol- and placebo-treated men with migraine without aura, The difference in the incidence of migraine-like attacks during the entire observational period (until 12 hours post-administration) between cilostazol-treated men and women with migraine without aura
Endpoint(s): The difference in the incidence of headache during the entire observational period (until 12 hours post-administration) between cilostazol- and placebo-treated men with migraine without aura, Difference in heart rate and mean arterial pressure until 90 minutes post-administration between cilostazol- and placebo-treated men with migraine without aura, Difference in the incidence of adverse events during the entire observational period (until 12 hours post-administration) between cilostazol- and placebo-treated men with migraine without aura

Source: https://euclinicaltrials.eu/ctis-public/view/2025-521520-29-00